EU clinical trial 2026-526840-10-00: Bioequivalence Study of Dapagliflozin 10 mg
Protocol code: VDAP/BIO/2026
Sponsor: Vipharm S.A. (Pharmaceutical company). Phase: Human Pharmacology (Phase I)- Bioequivalence Study. Countries: Czechia (authorised, recruitment pending).
Therapeutic area(s): Diseases [C] - Cardiovascular Diseases [C14]; Diseases [C] - Nutritional and Metabolic Diseases [C18]
Gender: Female, Male. Age: 18-64 years. Enrolment: 40.
Status: Authorised, recruitment pending. Decision date: 2026-07-02. Results received: No. Last updated: 2026-07-02.

Condition(s): Not applicable (submitted trial is a BE study in healthy participants)

Source: https://euclinicaltrials.eu/ctis-public/view/2026-526840-10-00